EU clinical trial 2024-513006-61-00: An open-label, multicentre, rollover study to evaluate safety and antineoplastic activity of OATD-02 in patients with selected advances and/or metastatic solid tumours who completed the first-in-human study OATD-02-C-01
Protocol code: OATD-02-C-02
Sponsor: Molecure S.A. (Pharmaceutical company). Phase: Human Pharmacology (Phase I)- Other. Countries: Poland (ongoing, recruiting).
Therapeutic area(s): Diseases [C] - Neoplasms [C04]
Gender: Female, Male. Age: 18-64 years, 65+ years. Enrolment: 30.
Status: Ongoing, recruiting. Start date (EU): 2023-08-23. Decision date: 2024-05-06. Results received: No. Last updated: 2026-02-19.

Condition(s): Advanced and/or metastatic solid tumours (colorectal cancer, ovarian cancer, pancreatic cancer or renal cell carcinoma)

Source: https://euclinicaltrials.eu/ctis-public/view/2024-513006-61-00